EU clinical trial 2023-507503-62-00: 17 β-Hydroxysteroid Dehydrogenase type 13 Minimization for the treatment of NASH (HORIZON): A Double-Blind, Placebo-Controlled Phase 2b Study to Evaluate the Efficacy and Safety of GSK4532990 in Adults with Nonalcoholic Steatohepatitis
Protocol code: 218672
Sponsor: Glaxosmithkline Research & Development Limited (Pharmaceutical company). Phase: Therapeutic exploratory (Phase II). Countries: Greece (ended), Italy (ended), Belgium (ended), Spain (ended), France (ended).
Therapeutic area(s): Diseases [C] - Digestive System Diseases [C06]
Gender: Female, Male. Age: 18-64 years. Enrolment: 52.
Status: Ended. Start date (EU): 2023-03-30. End date (EU): 2026-05-19. Decision date: 2024-03-08. Results received: No. Last updated: 2026-05-13.
Decision dates by country: FR: 2024-03-11, ES: 2024-03-11, BE: 2024-03-08, IT: 2024-03-11, GR: 2024-03-12

Condition(s): Non-alcoholic Fatty Liver Disease
Product: 0.9% Sodium Chloride Injection

Primary endpoint: "Achieving greater or equal to 1 stage improvement in histological fibrosis (Clinical Research Network [CRN] scoring) with no worsening of NASH (defined as no increase in the NAFLD Activity Score [NAS] for steatosis, ballooning, or inflammation) at 52 weeks. ", "Achieving NASH resolution with no worsening of fibrosis (defined as no increase in CRN fibrosis score) at 52 weeks. Resolution of NASH is defined as a ballooning score of 0 and an inflammation score of 0-1. "

Source: https://euclinicaltrials.eu/ctis-public/view/2023-507503-62-00